EU clinical trial 2025-522091-84-00: NeoMatryx - Neoadjuvant Merkel cell carcinoma therapy (Tx) with the PD-1 inhibitor Cemiplimab – A randomized, double-blind, placebo-controlled, non-comparative Phase II study
Protocol code: NeoMatryx
Sponsor: Frankfurter Institut Fuer Klinische Krebsforschung IKF GmbH (Pharmaceutical company). Phase: Therapeutic exploratory (Phase II). Countries: Germany (ongoing, recruiting).
Therapeutic area(s): Diseases [C] - Neoplasms [C04]
Gender: Female, Male. Age: 18-64 years, 65+ years. Enrolment: 135.
Status: Ongoing, recruiting. Start date (EU): 2026-05-29. Decision date: 2026-01-09. Results received: No. Last updated: 2026-07-20.
Decision dates by country: DE: 2026-03-09

Condition(s): Merkel Cell Carcinoma
Product: LIBTAYO 350 mg concentrate for solution for infusion., sodium chloride 9 mg/ml (0.9%) solution for injection

Primary endpoint: Nodal micrometastases-free rate defined as the rate of patients without nodal micrometastases after 2 cycles of treatment, determined by sentinel lymph node biopsy
Endpoint(s): Recurrence-free survival (RFS) defined as time from randomization until the date of the first of the following events: i. MCC progression or ii. MCC-related death (DSS), Overall survival (OS), defined as time from randomization until date of death from any cause, Disease specific survival (DSS), defined as time from randomization until date of MCC-related death, Quality of life (QoL) using: (i) FCRI-SF questionnaire (ii) mFACT-M questionnaire, Descriptive comparison of neoadjuvant Cemiplimab with placebo treatment prior to sentinel lymph node biopsy regarding: nodal micrometastases-free rate, RFS, TTR, OS, DSS, QoL, Assessment of safety of the treatment as determined by the incidence, nature, causality, frequency, timing and severity of adverse events using NCI CTCAE 5, Descriptive comparison of safety between neoadjuvant Cemiplimab and placebo treatment prior to sentinel lymph node biopsy, Correlation of identified biomarker with clinical outcome, i.e., nodal metastases-free rate, RFS, OS, Time to recurrence (TTR) defined as time from randomization until date of first MCC recurrence

Source: https://euclinicaltrials.eu/ctis-public/view/2025-522091-84-00